EU clinical trial 2023-503322-39-00: Phase Ib study of the combination of regorafenib with conventional chemotherapy for the treatment of newly diagnosed patients with multimetastatic Ewing sarcoma - REGO-INTER-EWING1
Protocol code: CSET2022/3545
Sponsor: Institut Gustave Roussy (Hospital/Clinic/Other health care facility). Phase: Human Pharmacology (Phase I)- Other. Countries: France (ongoing, recruitment ended), Netherlands (ongoing, recruitment ended), Italy (authorised, recruiting), Denmark (ongoing, recruitment ended), Spain (ended).
Therapeutic area(s): Diseases [C] - Musculoskeletal Diseases [C05]
Gender: Female, Male. Age: 0-17 years, 18-64 years. Enrolment: 22.
Start date (EU): 2023-06-16. Decision date: 2023-08-02. Results received: No. Last updated: 2026-04-22.
Decision dates by country: ES: 2024-07-22, DK: 2024-07-31, NL: 2023-11-23, IT: 2024-07-22, FR: 2023-08-02

Condition(s): Newly diagnosed patients with metastatic (other than lung/pleura metastases only) Ewing sarcoma
Product: BAY 73-4506, Regorafenib_PIP, Regorafenib_PIP

Primary endpoint: Dose-limiting toxicity (DLT) -DLT will be defined as any of the following haematological and non-haematological events (CTCAE v5.0) that occur during the DLT assessment period (4 weeks after the start of treatment = cycle 1) and are at least possibly related (possibly, probably, or definitely) attributable to VDC/IE + regorafenib, Any grade ≥ 3 (hematological or non-hematological) toxicity leading to delay of start of day 15 by > 7 days (i.e: starting > day 21) or day 1 of cycle 2 by > 14 days ((i.e: starting > day 42), Any dose interruption or reduction due to toxicity which results in administration of less than 80% of the planned dosage of regorafenib or 75% of the planned dosage of chemotherapy in the first cyle of 28 days of treatment., Any grade ≥ 3 toxicity resulting in permanent discontinuation of the regorafenib, Any grade 5 toxicity related to study treatment (death)
Endpoint(s): Overall Survival (OS) and progression-free survival (PFS), Adverse events and toxicity, defined by CTCAE v5.0, Histological response of the primary tumor to induction chemotherapy if surgery is performed as local control, Radiological response of primary tumor, regional lymph nodes and/or metastases

Source: https://euclinicaltrials.eu/ctis-public/view/2023-503322-39-00